EU clinical trial 2024-511270-72-00: Comparative Pharmacokinetic of S221237 Tablets in Healthy Participants Under Fed Conditions
Protocol code: S221237-176
Sponsor: Institut De Recherches Internationales Servier IRIS (Pharmaceutical company). Phase: Human Pharmacology (Phase I)- Other. Countries: Portugal (ended).
Therapeutic area(s): Not possible to specify
Gender: Male. Age: 18-64 years. Enrolment: 16.
Status: Ended. Start date (EU): 2024-06-13. End date (EU): 2024-07-21. Decision date: 2024-06-04. Results received: No. Last updated: 2024-06-28.

Condition(s): No medical condition

Source: https://euclinicaltrials.eu/ctis-public/view/2024-511270-72-00